EU clinical trial 2022-500647-21-00: A phase I/II randomized, assessor-blind, vehicle-controlled study to assess the safety, tolerability, and pharmacodynamics of DLQ03 in a wound healing model in patients with mild to moderate atopic dermatitis that are colonized with S. Aureus
Protocol code: DLQ03-001
Sponsor: Dermaliq Therapeutics Inc. (Pharmaceutical company). Phase: Phase I and Phase II (Integrated)- First administration to humans. Countries: Netherlands (ended).
Therapeutic area(s): Diseases [C] - Skin and Connective Tissue Diseases [C17]
Gender: Female, Male. Age: 18-64 years, 65+ years. Enrolment: 27.
Status: Ended. Start date (EU): 2022-08-04. End date (EU): 2023-11-21. Decision date: 2022-06-07. Results received: Yes. Last updated: 2023-07-26.
Decision dates by country: NL: 2022-08-12

Condition(s): Atopic dermatitis (Eczema)
Product: Perfluorohexyloctane, IODINE

Primary endpoint: Treatment-emergent (serious) adverse events ((S)AEs) throughout the study at every study visit, Concomitant medication throughout the study at every study visit, Vital signs (Pulse Rate (bpm), Systolic blood pressure (mmHg), Diastolic blood pressure (mmHg)) as per assessment schedule, Clinical laboratory tests (Hematology, blood chemistry and urinalysis) as per assessment schedule, ECG parameters (Heart Rate (HR) (bpm), PR, QRS, QT, QTcB, QTcF) as per assessment schedule, Local irritation grading scale

Source: https://euclinicaltrials.eu/ctis-public/view/2022-500647-21-00